EU clinical trial 2022-500430-29-00: A Phase 3, Open-label, Randomized Study to Compare the Efficacy and Safety of Luspatercept (ACE 536) vs Epoetin Alfa for the Treatment of Anemia Due to Revised International Prognostic Scoring System (IPSS-R) Very Low, Low, or Intermediate Risk Myelodysplastic Syndrome (MDS) in Erythropoiesis-stimulating Agent (ESA)-naive Participants who are Non-transfusion Dependent (NTD): The “ELEMENT-MDS” Trial
Protocol code: CA056-025
Sponsor: Celgene Corp. (Pharmaceutical company). Phase: Therapeutic confirmatory (Phase III). Countries: Czechia (ongoing, recruitment ended), Italy (ongoing, recruitment ended), Greece (ongoing, recruitment ended), Spain (ongoing, recruitment ended), France (ongoing, recruitment ended), Germany (ongoing, recruitment ended), Poland (ongoing, recruitment ended), Hungary (ongoing, recruitment ended).
Therapeutic area(s): Diseases [C] - Hemic and Lymphatic Diseases [C15]
Gender: Female, Male. Age: 18-64 years, 65+ years. Enrolment: 162.
Status: Ongoing, recruitment ended. Start date (EU): 2023-10-11. Decision date: 2023-10-03. Results received: No. Last updated: 2025-12-05.
Decision dates by country: PL: 2023-10-09, IT: 2023-10-04, FR: 2023-12-21, ES: 2023-10-05, GR: 2023-10-03, HU: 2023-10-09, CZ: 2023-10-05, DE: 2023-10-09

Condition(s): Myelodysplastic Syndrome (MDS)
Product: Binocrit 40,000 IU/1 ML solution for injection in a pre-filled syringe, Binocrit 20,000 IU/0.5 mL solution for injection in a pre-filled syringe, Binocrit 2,000 IU/1 mL solution for injection in a pre-filled syringe, Binocrit 6,000 IU/0.6 ML solution for injection in a pre-filled syringe, Binocrit 4,000 IU/0.4 ML solution for injection in a pre-filled syringe, Reblozyl 75 mg powder for solution for injection, Reblozyl 25 mg powder for solution for injection, Binocrit 30,000 IU/0.75 ML solution for injection in a pre-filled syringe

Primary endpoint: Conversion to TD (IWG 2018 defined as ≥ 3 units/16 weeks) during any continuous 16-week interval within the 96-week Treatment Period
Endpoint(s): Achievement of an increase in mean Hb values from baseline of ≥ 1.5 g/dL in any continuous 16-week interval within the 48-week Treatment Period in the absence of transfusion

Source: https://euclinicaltrials.eu/ctis-public/view/2022-500430-29-00